EU clinical trial 2025-524395-30-00: Discontinuation or Continuation of SGLT-2 Inhibitors Before Cardiac Surgery: Impact on Postoperative Cardiovascular Outcomes – DISCO Study
Protocol code: RC31/25/0443
Sponsor: Centre Hospitalier Universitaire De Toulouse (Hospital/Clinic/Other health care facility). Phase: Therapeutic use (Phase IV). Countries: France (authorised, recruitment pending).
Therapeutic area(s): Diseases [C] - Cardiovascular Diseases [C14]
Gender: Female, Male. Age: 18-64 years, 65+ years. Enrolment: 458.
Status: Authorised, recruitment pending. Decision date: 2026-05-29. Results received: No. Last updated: 2026-05-29.

Condition(s): heart failure
Product: METFORMIN AND DAPAGLIFLOZIN, DAPAGLIFLOZIN, METFORMIN AND EMPAGLIFLOZIN, EMPAGLIFLOZIN

Primary endpoint: composite endpoint, describing postoperative cardiovascular outcomes, namely: – Perioperative myocardial injury within the first 48 hours postoperatively, defined by an increase in high-sensitivity troponin I (HS). – Low cardiac output syndrome within 7 days postoperatively – Rehospitalisation at 30 days postoperatively for left heart failure – All-cause mortality at 30 days postoperatively.
Endpoint(s): Postoperative myocardial injury within the first 48 hours after surgery, defined by an increase in high-sensitivity troponin I (HS). The thresholds will be 218 times the laboratory threshold value for patients undergoing coronary artery bypass grafting or aortic valve replacement or repair surgery. For patients undergoing other types of cardiac surgery, the threshold will be 499 times the laboratory threshold value., Postoperative low cardiac output syndrome occurring within 7 days postoperatively, defined by infusion of positive inotropes for more than 48 hours and/or the need for temporary mechanical circulatory support postoperatively (ECLS, CPIA, Impella®)., Rehospitalisation within 30 days of surgery for left heart failure defined by the need for introduction or increase in diuretics and/or administration of positive inotropes and/or use of invasive or non-invasive ventilation for acute pulmonary oedema. Only stays in cardiology departments, including intensive care, cardiac surgery or resuscitation, will be considered., All-cause mortality a) at 30 days b) at 7 days, Euglycaemic ketoacidosis defined by a pH < 7.35 and the presence of capillary ketonemia > 0.6 mmol/l and capillary blood glucose < 2.5 g/l within 7 days post-operatively., Acute renal failure defined as a KDIGO (Kidney Disease Improving Global Outcome) score ≥ 2, occurring in intensive care within 7 days., The delay in days before postoperative resumption of SGLT-2 inhibitors, Quality of life will be assessed using an EQ5D test carried out the day before surgery and on day 30., Length of stay in intensive care in days, Length of hospital stay in days

Source: https://euclinicaltrials.eu/ctis-public/view/2025-524395-30-00